EU clinical trial 2024-519291-11-00: A Phase 2 Multicenter, Randomized, Platform Study of Targeted Therapies for the Treatment of Adult Subjects with Active Psoriatic Arthritis
Protocol code: M25-191
Sponsor: AbbVie Deutschland GmbH & Co. KG (Pharmaceutical company). Phase: Therapeutic exploratory (Phase II). Countries: Czechia (ongoing, recruiting), Poland (ongoing, recruiting), France (ongoing, recruiting), Hungary (ongoing, recruiting).
Therapeutic area(s): Diseases [C] - Immune System Diseases [C20]
Gender: Female, Male. Age: 18-64 years, 65+ years. Enrolment: 63.
Status: Ongoing, recruiting. Start date (EU): 2025-07-25. Decision date: 2025-06-25. Results received: No. Last updated: 2026-02-09.
Decision dates by country: PL: 2025-07-07, HU: 2025-07-07, FR: 2025-06-25, CZ: 2025-07-02

Condition(s): Psoriatic Arthritis
Product: ABBV-066, Lutikizumab

Primary endpoint: Percentage of Participants With an American College of Rheumatology 50% (ACR50) Response at Week 16
Endpoint(s): Percentage of Participants Achieving Minimal Disease Activity (MDA) Response at Week 16, Percentage of Participants With an American College of Rheumatology 20% (ACR20) Response at Week 16, Percentage of Participants With an American College of Rheumatology 70% (ACR70) Response at Week 16, Percentage of Participants Achieving Psoriasis Area Severity Index (PASI) 75 Response at Week 16 (in the subset of participants with a PsO BSA ≥ 3% at Baseline)

Source: https://euclinicaltrials.eu/ctis-public/view/2024-519291-11-00